EU clinical trial 2023-506859-13-00: Randomized, Multicenter, Phase III, Open-Label Study of Alectinib Versus Crizotinib In Treatment-Naive Anaplastic Lymphoma Kinase-Positive Advanced Non-Small Cell Lung Cancer
Protocol code: BO28984
Sponsor: F. Hoffmann-La Roche AG (Pharmaceutical company). Phase: Therapeutic confirmatory (Phase III). Countries: Poland (ended), Spain (ended), Portugal (ended), Italy (ended).
Therapeutic area(s): Diseases [C] - Neoplasms [C04]
Gender: Female, Male. Age: 18-64 years, 65+ years. Enrolment: 51.
Status: Ended. Start date (EU): 2014-09-09. End date (EU): 2025-03-14. End date: 2025-04-09. Decision date: 2024-07-17. Results received: Yes. Last updated: 2025-04-22.
Decision dates by country: ES: 2024-07-17, PL: 2024-08-06, IT: 2024-07-22, PT: 2024-07-17

Condition(s): Anaplastic lymphoma kinase (ALK)-positive non-small cell lung cancer (NSCLC)
Product: XALKORI 200 mg hard capsules, Alecensa 150 mg hard capsules, XALKORI 200 mg hard capsules, Alectinib (Alecensa), XALKORI 250 mg hard capsules, XALKORI 250 mg hard capsules

Primary endpoint: 1. PFS, as assessed by investigator
Endpoint(s): 1. PFS by IRC, 2. Time to CNS Progression by IRC, 3. ORR as determined by the investigators using RECIST v1.1., 4. DOR, 5. Time to deterioration (TTD) in patient-reported lung cancer symptoms, 6. Health-related quality of life (HRQoL), 7. Safety and tolerability, 8. Pharmacokinetics of alectinib and metabolite(s), 9. Overall survival (OS)

Source: https://euclinicaltrials.eu/ctis-public/view/2023-506859-13-00